EU clinical trial 2025-523539-20-00: A Phase 2A/B, Multi-center, Open-Label Study Evaluating the Efficacy and Safety of Dabogratinib (TYRA-300) in Participants with Low Grade Upper Tract Urothelial Carcinoma (SURF303)
Protocol code: TYR300-203
Sponsor: Tyra Biosciences Inc. (Pharmaceutical company). Phase: Therapeutic exploratory (Phase II). Countries: Bulgaria (ended), France (authorised, recruitment pending), Spain (authorised, recruiting).
Therapeutic area(s): Diseases [C] - Neoplasms [C04]
Gender: Female, Male. Age: 18-64 years, 65+ years. Enrolment: 34.
Start date (EU): 2026-07-09. Decision date: 2026-05-28. Results received: No. Last updated: 2026-06-24.
Decision dates by country: FR: 2026-05-28, ES: 2026-06-01, BG: 2026-06-01

Condition(s): Low Grade Upper Tract Urothelial Carcinoma

Primary endpoint: Phase 2A: 1. Complete Response rate within 6 months. 2. Determination of the recommended dose for Phase 2B based on integrated safety, PK and efficacy data, Phase 2B: Complete Response rate within 6 months.
Endpoint(s): 1. Complete Response rate within 6 months., 2. Duration of Response in participants with LG UTUC with FGFR3 altered tumours; Complete Response rate in 12months and 24 months. Response rate within 6 months., 3. Incidence and severity of Adverse Events, 4. PK parameters may include Cmax, Tmax, AUC0-last, AUCTau, AUC0-infinity, Vd/F, CL/F, and t1/2., 5. Proportion of participants who did not undergo nephrectomy or nephroureterectomy, 6. Proportion of participants with unresectable disease at baseline who convert to resectable disease or CR on dabogratinib, as assessed by the Investigator

Source: https://euclinicaltrials.eu/ctis-public/view/2025-523539-20-00